EU clinical trial 2024-518320-71-00: Efficacy of low dose amitriptyline vs. cognitive behavioural therapy for chronic insomnia and medical comorbidity: a randomized controlled non inferiority trial.
Protocol code: MP-2019-001
Sponsor: Ziekenhuis Gelderse Vallei Stichting (Hospital/Clinic/Other health care facility). Phase: Phase III and phase IV (Integrated). Countries: Netherlands (ended).
Therapeutic area(s): Psychiatry and Psychology [F] - Psychological Phenomena [F02]
Gender: Female, Male. Age: 18-64 years, 65+ years. Enrolment: 190.
Status: Ended. Start date (EU): 2024-10-29. End date (EU): 2026-01-14. Decision date: 2024-10-29. Results received: Yes. Last updated: 2024-10-29.

Condition(s): insomnia
Product: Amitriptyline HCl CF 10 mg, filmomhulde tabletten

Primary endpoint: The mean subjective insomnia severity score, measured by the insomnia severity index (ISI) at 12 weeks
Endpoint(s): Sleep quality quantified by sleep efficiency (by sleep diary), Daytime functioning and symptoms (fatigue, emotional complaints, physical functioning, impairment of functioning)., Adverse events and treatment evaluation (side effects, withdrawal symptoms, and adherence)

Source: https://euclinicaltrials.eu/ctis-public/view/2024-518320-71-00